EU clinical trial 2023-509684-24-00: Four-part, Randomized, Double-blind (Parts 1, 2A, 3 and 4), Multi-center, Placebo-controlled Study to Assess the Safety, Tolerability, Pharmacokinetics, and Pharmacodynamics of GSK3965193 Monotherapy in Healthy Participants and in Participants Living with Chronic Hepatitis B Infection; and GSK3965193 in Combination with Bepirovirsen in Participants Living with Chronic Hepatitis B Infection
Protocol code: 214760
Sponsor: Glaxosmithkline Research & Development Limited (Pharmaceutical company). Phase: Phase I and Phase II (Integrated)- First administration to humans. Countries: France (ended), Italy (ended).
Therapeutic area(s): Diseases [C] - Virus Diseases [C02]
Gender: Female, Male. Age: 18-64 years. Enrolment: 24.
Status: Ended. Start date (EU): 2024-10-31. End date (EU): 2025-12-16. End date: 2026-04-08. Decision date: 2024-08-20. Results received: No. Last updated: 2025-12-05.
Decision dates by country: FR: 2024-08-26, IT: 2024-08-20

Condition(s): Hepatitis B
Product: Placebo to Match GSK3965193 Tablets

Primary endpoint: Incidence of AEs, SAEs, withdrawals due to AEs, Incidence of clinically significant laboratory parameters (haematology, clinical chemistry, urinalysis), vital signs, cardiac parameters (electrocardiogram), and sensory nerve conduction, In Part 3 - Maximum reduction of serum HBsAg levels from baseline over 6 weeks (4 weeks on treatment and 2 weeks post-treatment), In Part 4 - Achieving complete response (undetectable serum HBV DNA and HBsAg for 6 consecutive months after the planned end of treatment of bepirovirsen)
Endpoint(s): In Part 3 - AUC(0-tau), Cmax, Tmax, and apparent terminal half-life (T1/2) will be calculated as data permits, In Part 3 - >=0.5x log IU/mL reduction of serum HBsAg levels from baseline anytime during the study (on-treatment and post-treatment), In Part 3 - Incidence of AEs, SAEs, withdrawals due to AEs and incidence of clinically significant laboratory parameters (haematology, clinical chemistry, urinalysis) and vital signs occurring in participants taking bepirovirsen monotherapy after completing GSK3965193/placebo monotherapy, In Part 4 - HBsAg loss (defined by two consecutive measurements of HBsAg below the limit of quantification) anytime during the study (on-treatment and post-treatment)

Source: https://euclinicaltrials.eu/ctis-public/view/2023-509684-24-00